EU clinical trial 2024-513429-21-00: PaTcH Trial: A phase 2 study to explore primary and emerging resistance mechanisms in patients with metastatic refractory Pancreatic cancer treated with Trametinib and Hydrochloroquine.
Protocol code: 20-27 PaTcH
Sponsor: Cancer Trials Ireland (Patient organisation/association). Phase: Therapeutic exploratory (Phase II). Countries: Ireland (ended).
Therapeutic area(s): Diseases [C] - Neoplasms [C04]
Gender: Female, Male. Age: 18-64 years, 65+ years. Enrolment: 22.
Status: Ended. Start date (EU): 2023-06-27. End date (EU): 2026-06-29. Decision date: 2024-06-18. Results received: No. Last updated: 2025-07-07.

Condition(s): Metastatic refractory Pancreatic Cancer
Product: Mekinist 2 mg film-coated tablets, Hydroxychloroquine sulfate Accord 200mg film-coated tablets, Mekinist 0.5 mg film-coated tablets

Primary endpoint: Anti-tumour efficacy of tx will be primarily measured as 12W PFS: Percentage of patients free of progression at 12W from starting treatment into the study as determined by radiographic disease assessments per RECIST version 1.1. Planned efficacy assessments will occur by CT TAP at baseline, 6W, 12W post starting treatment and then q-8 weekly until disease progression or consent withdrawal.
Endpoint(s): Confirmed tumour response rate and duration of response as assessed by RECIST version 1.1., Overall survival, To evaluate the safety and tolerability of this regimen as measured by incidence of adverse events reported and toxicity evaluation as per the National Cancer Institute’s Common Terminology Criteria for Adverse Events (NCI CTCAE) version 5.0.

Source: https://euclinicaltrials.eu/ctis-public/view/2024-513429-21-00